EU clinical trial 2023-509239-19-00: A Phase 3, Multicenter, Randomized, Double-blind, Placebo-controlled Study Evaluating the Efficacy and Safety of JNJ-77242113 for the Treatment of Biologic-naïve Participants with Active Psoriatic Arthritis
Protocol code: 77242113PSA3001
Sponsor: Janssen Cilag International (Pharmaceutical company). Phase: Therapeutic confirmatory (Phase III). Countries: Spain (ongoing, recruitment ended), Poland (ongoing, recruitment ended), Czechia (ongoing, recruitment ended), Denmark (ongoing, recruitment ended), Germany (ongoing, recruitment ended), Bulgaria (ongoing, recruitment ended), Hungary (ongoing, recruitment ended).
Therapeutic area(s): Diseases [C] - Immune System Diseases [C20]
Gender: Female, Male. Age: 18-64 years, 65+ years. Enrolment: 337.
Status: Ongoing, recruitment ended. Start date (EU): 2025-04-03. Decision date: 2025-04-02. Results received: No. Last updated: 2026-08-06.
Decision dates by country: BG: 2025-04-07, CZ: 2025-04-04, DK: 2025-04-02, DE: 2025-04-02, PL: 2025-04-14, ES: 2025-04-03, HU: 2025-04-10

Condition(s): Active Psoriatic Arthritis
Product: JNJ-77242113, STELARA 45 mg solution for injection, JNJ-77242113-AAC Placebo tablet, Solution for injection in pre-filled syringe without Ustekinumab 45, Solution for injection in pre-filled syringe without Ustekinumab 90, STELARA 90 mg solution for injection in pre-filled syringe

Primary endpoint: The primary endpoint is the American College of Rheumatology (ACR) 20 response at Week 16

Source: https://euclinicaltrials.eu/ctis-public/view/2023-509239-19-00